EU clinical trial 2023-506442-24-00: C5091013 - A Phase 1, Open-Label, Randomized, Single Dose, Crossover Study to Estimate the Relative Bioavailability of PF-07817883 Following Oral Administration of New Formulations Relative to The Reference Formulation in Healthy Adult Participants Under Fasted Condition
Protocol code: C5091013
Sponsor: Pfizer Inc. (Pharmaceutical company). Phase: Human Pharmacology (Phase I)- Other. Countries: Belgium (ended).
Therapeutic area(s): Diseases [C] - Virus Diseases [C02]
Gender: Female, Male. Age: 18-64 years, 65+ years. Enrolment: 12.
Status: Ended. Start date (EU): 2023-11-15. End date (EU): 2024-01-12. End date: 2024-01-13. Decision date: 2023-10-13. Results received: Yes. Last updated: 2023-11-09.

Condition(s): coronavirus disease 2019
Product: PF-07817883 Tablet / 23-DP-01696, PF-07817883 Tablet / 23-DP-01687, PF-07817883 Tablet / 23-DP-01526, PF-07817883 Tablet / 23-DP-01449

Primary endpoint: Cmax and AUCinf if data permit, otherwise AUClast
Endpoint(s): Assessment of TEAEs, clinical laboratory abnormalities, vital signs, and 12-lead ECGs.

Source: https://euclinicaltrials.eu/ctis-public/view/2023-506442-24-00